EU clinical trial 2023-506206-38-00: A combination of Rituximab and CC-99282 as front-line therapy for older frail patients with Diffuse Large B-cells non-Hodgkin Lymphoma evaluated with a simplified Geriatric Assessment (sGA): a phase II study of the Fondazione Italiana Linfomi (FIL).
Protocol code: FIL_RICCO
Sponsor: Fondazione Italiana Linfomi Ets (Patient organisation/association). Phase: Therapeutic exploratory (Phase II). Countries: Italy (ongoing, recruiting).
Therapeutic area(s): Diseases [C] - Hemic and Lymphatic Diseases [C15]
Gender: Female, Male. Age: 65+ years. Enrolment: 47.
Status: Ongoing, recruiting. Start date (EU): 2025-04-09. Decision date: 2025-02-11. Results received: No. Last updated: 2026-04-29.

Condition(s): Diffuse Large B-cells non-Hodgkin Lymphoma
Product: RITUXIMAB, Golcadomide

Primary endpoint: Progression free survival (PFS)
Endpoint(s): Overall response rate (partial response, PR + complete response, CR) after the 6th cycle, Overall survival (OS), Rate of treatment discontinuation due to AE or treatment intolerance, Change in QoL assessment from baseline at 6 months and 12 months by EORTC QLQ C-30 and FACT-Lym questionnaires

Source: https://euclinicaltrials.eu/ctis-public/view/2023-506206-38-00